EU clinical trial 2024-515868-31-00: A Phase 3a, observer-blind, randomized, controlled study to evaluate the safety of an investigational varicella vaccine compared with Varivax, administered as a first dose to healthy children 12 to 15 months of age.
Protocol code: 213997 (VNS 20-001)
Sponsor: GlaxoSmithKline Biologicals (Pharmaceutical company). Phase: Therapeutic confirmatory (Phase III). Countries: Lithuania (ongoing, recruiting), Poland (ongoing, recruitment ended), Bulgaria (ongoing, recruiting), Estonia (ongoing, recruiting), Denmark (ongoing, recruiting).
Therapeutic area(s): Diseases [C] - Virus Diseases [C02]
Gender: Female, Male. Age: 0-17 years. Enrolment: 365.
Start date (EU): 2025-06-10. Decision date: 2025-05-05. Results received: No. Last updated: 2026-08-06.
Decision dates by country: BG: 2025-05-09, LT: 2025-05-06, DK: 2025-05-13, EE: 2025-05-08, PL: 2025-05-12

Condition(s): Varicella
Product: VARIVAX® Pulver und Lösungsmittel zur Herstellung einer Injektionssuspension in einer Fertigspritze Varizellen-Lebendimpfstoff, VARIVAX® Pulver und Lösungsmittel zur Herstellung einer Injektionssuspension in einer Fertigspritze Varizellen-Lebendimpfstoff

Primary endpoint: Occurrence of solicited: •administration site events within 4 days (Day 1 to Day 4) post dose of VNS vaccine or VV administration. •systemic events within 15 days (Day 1 to Day 15) post-dose of study interventions administration. •systemic event (fever) within 22 days (Day 1 to Day 22) post-dose of study interventions administration. •administration site and systemic events (rash) within 43 days (Day 1 to Day 43) post-dose of study interventions administration., Occurrence of any unsolicited AEs within 43 days (Day 1 to Day 43) post-dose of study interventions administration., Occurrence of any medically attended AEs post-dose of study interventions administration up to study end (Day 181)., Occurrence of SAEs post-dose of study interventions administration up to study end.

Source: https://euclinicaltrials.eu/ctis-public/view/2024-515868-31-00